EU clinical trial 2022-502096-32-00: A Randomized, Double-blind, Placebo-controlled, Phase 1/2 Study to Evaluate the Safety, Tolerability, Pharmacokinetics, Pharmacodynamics, and Exploratory Efficacy of AOC 1020 Administered Intravenously to Adult Participants with Facioscapulohumeral Muscular Dystrophy (FSHD)
Protocol code: AOC 1020-CS1
Sponsor: Avidity Biosciences Inc. (Pharmaceutical company). Phase: Phase I and Phase II (Integrated)- First administration to humans. Countries: Netherlands (ended), Italy (ended).
Therapeutic area(s): Diseases [C] - Musculoskeletal Diseases [C05]
Gender: Female, Male. Age: 18-64 years, 65+ years. Enrolment: 12.
Status: Ended. End date (EU): 2023-11-29. End date: 2026-03-20. Decision date: 2023-07-25. Results received: No. Last updated: 2023-12-11.
Decision dates by country: IT: 2023-07-26, NL: 2023-07-25

Condition(s): Facioscapulohumeral muscular dystrophy (FSHD)
Product: The placebo for this study is saline (0.9% sodium chloride water for injection) for intravenous infusion administration and will be provided by the study site., AOC 1020

Primary endpoint: Incidence of treatment-emergent adverse events
Endpoint(s): Estimation of plasma PK parameters, including maximum plasma concentration, half-life, and area under the curve of AOC 1020, Concentration of siRNA component in skeletal muscle (Day 120)

Source: https://euclinicaltrials.eu/ctis-public/view/2022-502096-32-00